EU clinical trial 2024-517647-31-00: Evaluation of efficacy and safety of Cemiplimab as first line treatment for advanced basal cell carcinoma (CEMI-first) - An open label, single arm, prospective phase II trial of the DeCOG network
Protocol code: CEMI-first
Sponsor: Frankfurter Institut Fuer Klinische Krebsforschung IKF GmbH (Pharmaceutical company). Phase: Therapeutic exploratory (Phase II). Countries: Germany (ongoing, recruiting).
Therapeutic area(s): Diseases [C] - Neoplasms [C04]
Gender: Female, Male. Age: 18-64 years, 65+ years. Enrolment: 34.
Status: Ongoing, recruiting. Start date (EU): 2025-07-09. Decision date: 2025-02-28. Results received: No. Last updated: 2026-07-03.

Condition(s): basal cell carcinoma
Product: LIBTAYO 350 mg concentrate for solution for infusion.

Primary endpoint: ORR@6months is defined as the rate of patients assessed with complete or partial response (CR or PR) according to ERIVANCE-like criteria as best overall response, relative to the total number of patients as evaluated 6 months after treatment allocation.
Endpoint(s): ORR is defined as the rate of patients assessed with complete or partial response (CR or PR) as best overall response, relative to the total number of patients., PFS is defined as time from date of allocation to treatment to the date of the first objectively documented tumor progression, as determined by investigators, or death due to any cause., DoR is defined as length of time from initial response (CR/PR) to first objectively documented progression or death., OS defined as time from date of allocation to treatment until the date of death from any cause., Time to next systemic treatment is defined as time from date of allocation to treatment to initiation of the next line of systemic therapy., Incidence of adverse events and serious adverse events, Severity of adverse events by CTCAE v5.0 grade, Relationship of adverse events to Cemiplimab, Incidence of adverse events and serious adverse events, Severity of adverse events by CTCAE v5.0 grade, Relationship of adverse events to Cemiplimab, Tissue samples may be used for the following analyses: - Morphology (H&E and trichrome/connective tissue stain) - Multiplexed immunofluoresence with panels addressing T-cell activation and differentiation as well as the immunomodulating tumor microenvironment - Transcriptomics (EdgeSeq-based mRNA expression) - Infered tumor mutational burden (TMB) - TCR repertoire. Blood samples will be used for TCR repertoire analysis at the central biomarker laboratory.

Source: https://euclinicaltrials.eu/ctis-public/view/2024-517647-31-00